EU clinical trial 2024-515039-31-00: Isatuximab in type I cryoglobulinemia: A prospective pilot study / ICE STUDY
Protocol code: APHP210369
Sponsor: Assistance Publique Hopitaux De Paris (Hospital/Clinic/Other health care facility). Phase: Therapeutic exploratory (Phase II). Countries: France (ended).
Therapeutic area(s): Diseases [C] - Immune System Diseases [C20]
Gender: Female, Male. Age: 18-64 years, 65+ years. Enrolment: 21.
Status: Ended. Start date (EU): 2022-02-10. End date (EU): 2025-01-28. Decision date: 2024-11-29. Results received: No. Last updated: 2024-11-29.

Condition(s): Isatuximab in type I cryoglobulinaemia: A prospective pilot study
Product: ISATUXIMAB

Primary endpoint: Complete clinical response rate of cryoglobulinemia vasculitis symptoms at week (W) 20
Endpoint(s): Safety and tolerability of treatment as assessed by frequency and severity of adverse clinical events at W20, Complete, partial and non-clinical response rate at W12, and at W20., Rate of cryoglobulinemia clearance, of negativation of rheumatoid factor activity and of normalization of C4 complement level at W12, and at W20., Rate of early failures (non-clinical response at W4),, Rate of renal complete remission defined as proteinuria <0.5g/24h or proteinuria/creatininuria <50 mg/mmol, disappearance of hematuria, and glomerular filtration rate ≥ 60ml/min/1.73m² at W12, and at W20., Clinical relapse rate defined by de novo appearance or reappearance of a manifestation attributable to cryoglobulinemia vasculitis during 48 weeks of follow-up,, Rate and time to relapse from baseline to W48, Course of plasma cell associated disorder W12, and at W20., Mean change of gammaglobulin level from baseline to W20, Quality of life assessed by the mean variation of the SF-36 over the 20 weeks,, Rate of infections (severe or not) and other complications during the 48 weeks of follow-up, Proportion of patients remaining in remission with a BVAS=0 at baseline, W12, and W20., Evolution of Immunomonitoring (deep immunophenotyping, cytokines production, spectrometry, Fish analysis, single plasma cell repertoire) at baseline, week 12, and week 20

Source: https://euclinicaltrials.eu/ctis-public/view/2024-515039-31-00